EU clinical trial 2024-512135-80-00: An Open-Label, Multicenter Phase 2 Basket Study to Evaluate the Antitumor Activity and Safety of Lenvatinib in Children, Adolescents, and Young Adults with Relapsed or Refractory Solid Malignancies
Protocol code: MK-7902-013
Sponsor: Merck Sharp & Dohme LLC (Pharmaceutical company). Phase: Therapeutic exploratory (Phase II). Countries: Spain (ended), Italy (ended), France (ended), Czechia (ended).
Therapeutic area(s): Diseases [C] - Neoplasms [C04]
Gender: Female, Male. Age: 0-17 years, 18-64 years. Enrolment: 57.
Status: Ended. Start date (EU): 2020-07-13. End date (EU): 2025-02-05. End date: 2025-02-13. Decision date: 2024-06-18. Results received: Yes. Last updated: 2024-11-28.
Decision dates by country: CZ: 2024-08-26, FR: 2024-06-24, IT: 2024-08-20, ES: 2024-06-20

Condition(s): Between ages 2 and 21 and have High Grade Glioma (HGG), Rhabdomyosarcoma (RMS), Ewing Sarcoma/Peripheral Primitive Neuroectodermal Tumor (pPNET), or other solid tumor types (except osteosarcoma)
Product: Lenvatinib, Lenvatinib, Lenvatinib

Primary endpoint: 1. Objective Response Rate (ORR) At Week 16 per Response Evaluation Criteria In Solid Tumors version 1.1 (RECIST 1.1) or Response Assessment in Neuro-Oncology (RANO) Criteria (for High Grade Glioma [HGG] only), by Investigator Assessment
Endpoint(s): 1. ORR per RECIST 1.1 or RANO Criteria (for HGG only), by Investigator Assessment, 2. Progression Free Survival (PFS) per RECIST 1.1 or RANO (for HGG only), by Investigator Assessment, 3. Best Overall Response (BOR) per RECIST 1.1 or RANO (for HGG only), by Investigator Assessment, 4. Duration of Response (DOR) per RECIST 1.1 or RANO (for HGG only), by Investigator Assessment, 5. Disease Control Rate (DCR) per RECIST 1.1 or RANO (for HGG only), by Investigator Assessment, 6. Clinical Benefit Rate (CBR) per RECIST 1.1 or RANO (for HGG only), by Investigator Assessment, 7. Number of Participants who Experience an Adverse Event (AE), 8. Number of Participants who Discontinue Study Treatment Due to an AE, 9. Palatability Questionnaire Score For Lenvatinib Suspension Formulation, 10. Area Under the Concentration-Time Curve of lenvatinib From Time 0 to Infinity (AUC 0-inf)

Source: https://euclinicaltrials.eu/ctis-public/view/2024-512135-80-00